EU clinical trial 2024-518810-23-00: Shorter weaning from invasive ventilation with levosimendan: a randomized, double-blind, multicenter study in critically ill patients.
Protocol code: PaNaMa ID: 116348
Sponsor: Radboud universitair medisch centrum Stichting (Hospital/Clinic/Other health care facility). Phase: Therapeutic use (Phase IV). Countries: Netherlands (ongoing, recruiting).
Therapeutic area(s): Diseases [C] - Respiratory Tract Diseases [C08]
Gender: Female, Male. Age: 18-64 years, 65+ years. Enrolment: 250.
Status: Ongoing, recruiting. Start date (EU): 2025-09-17. Decision date: 2025-05-13. Results received: No. Last updated: 2026-07-01.
Decision dates by country: NL: 2025-05-15

Condition(s): Failure to wean from invasive ventilation.
Product: Levosimendan Kalceks 2,5 mg/ml concentraat voor oplossing voor infusie, Soluvit N poeder voor oplossing voor intraveneuze infusie

Primary endpoint: The number of ventilator-free days (VFD) from randomization up until day 28.
Endpoint(s): The number of ventilator-free days from randomization up day 90., The number of days from randomization to successful weaning from invasive mechanical ventilation., ICU mortality; Mortality at 28 days and 90 days post randomization., Safety endpoints: hypotension, cardiac dysrhythmia (atrial fibrillation, ventricular arrythmias), change in dose of vasopressors after randomization, change in fluid balance after randomization., Dyspnea sensation. Dyspnea will be assessed daily at the end of the spontaneous breathing trial using the Visual Analogue Scale (VAS)., EQ-5D-5L scores at baseline and at follow up after 3 and 12 months., Reintubation (for endotracheally intubated patients) or reinstitution of invasive ventilation (for tracheostomized patients) within 7 days after liberation. An endotracheal intubation beyond 7 days is not considered a “reintubation” but will be classified as an intubation for new event within 90 days.., ICU readmission within 90 days., The number of days with non-invasive respiratory support (high flow nasal canula or non-invasive ventilation) < 28 days after randomization., The length of stay in the ICU., Levosimendan and its metabolite pharmacokinetics assessed for up to 7 days., The length of stay in the hospital.

Source: https://euclinicaltrials.eu/ctis-public/view/2024-518810-23-00